EU clinical trial 2023-508454-26-00: Randomized Multi-center Clinical Trial to Assess Effectiveness and Safety of Tirofiban Versus Intravenous Aspirin in Patients With Acute Ischemic Stroke Secondary to Tandem Injury, Subject to Recanalization Therapy Through Endovascular Treatment
Protocol code: ATILA-ictus-2021
Sponsor: Fundacion Publica Andaluza Para La Gestion De La Investigacion En Salud De Sevilla (Laboratory/Research/Testing facility). Phase: Therapeutic use (Phase IV). Countries: Spain (ended).
Therapeutic area(s): Diseases [C] - Cardiovascular Diseases [C14]
Gender: Female, Male. Age: 18-64 years, 65+ years. Enrolment: 240.
Status: Ended. Start date (EU): 2022-05-01. End date (EU): 2026-03-20. Decision date: 2024-04-30. Results received: No. Last updated: 2024-04-30.

Condition(s): Acute Ischemic Stroke
Product: Clopidogrel TecniGen 75 mg comprimidos recubiertos con película EFG, A.A.S. 100 mg comprimidos., Inyesprin, AGRASTAT 50 microgrammes/ml, solution pour perfusion

Primary endpoint: Carotid Reocclusion, Platelet aggregation phenomena, Symptomatic intracranial hemorrhage (sICH)
Endpoint(s): Good functional prognosis, Defined as a score on the modified rankin scale (mRS) between 0-2 at 90 days.

Source: https://euclinicaltrials.eu/ctis-public/view/2023-508454-26-00